EU clinical trial 2022-503036-13-00: Prostate-specific membrane antigen in thyroid and head and neck carcinoma: On the utility of [18F]AlF-PSMA-11 PET in advanced disease
Protocol code: PANTHEON-18
Sponsor: Universitair Ziekenhuis Gent (Hospital/Clinic/Other health care facility). Phase: Therapeutic exploratory (Phase II). Countries: Belgium (ongoing, recruiting).
Therapeutic area(s): Analytical, Diagnostic and Therapeutic Techniques and Equipment [E] - Investigative Techniques [E05]; Diseases [C] - Otorhinolaryngologic Diseases [C09]; Diseases [C] - Neoplasms [C04]; Analytical, Diagnostic and Therapeutic Techniques and Equipment [E] - Diagnosis [E01]
Gender: Female, Male. Age: 18-64 years, 65+ years. Enrolment: 40.
Status: Ongoing, recruiting. Start date (EU): 2024-02-01. Decision date: 2023-08-16. Results received: No. Last updated: 2025-10-07.

Condition(s): Head and neck squamous cell carcinoma, thyroid carcinoma
Product: [18F]PSMA-11

Primary endpoint: qualitative count of lesions with significant [¹⁸F]AlF-PSMA-11 uptake on PET. For each subject, all endpoints are measured within 12 months after the last trial-specific intervention (trial-specific PET/CT or blood sampling) for that subject (LTIS). For the whole trial, all endpoints are measured within 12 months after the overall last trial-specific intervention (LTI), that is, after the last of all LTISs. (analyse PET images and blood and tissue samples until 12 months after the overall LTISs)
Endpoint(s): semiquantitative lesion radiotracer [¹⁸F]AlF-PSMA-11 uptake values on PET. For each subject, all endpoints are measured within 12 months after LTIS. For the whole trial, all endpoints are measured within 12 months after LTI.(analyse PET images and blood and tissue samples until 12 months after the overall LTISs), semiquantitative organ-level radiotracer [¹⁸F]AlF-PSMA-11 uptake values on PET. For each subject, all endpoints are measured within 12 months after LTIS. For the whole trial, all endpoints are measured within 12 months after LTI.(analyse PET images and blood and tissue samples until 12 months after the overall LTISs)

Source: https://euclinicaltrials.eu/ctis-public/view/2022-503036-13-00